EU clinical trial 2022-502646-27-00: A Phase 2/3 Multicenter, Open-label, Randomized, Active-Control Study of Zilovertamab Vedotin (MK-2140) in Combination With Standard of Care in Participants With Relapsed or Refractory Diffuse Large B-Cell Lymphoma (waveLINE-003)
Protocol code: MK-2140-003
Sponsor: Merck Sharp & Dohme LLC (Pharmaceutical company). Phase: Phase II and Phase III (Integrated). Countries: France (ongoing, recruiting), Italy (ongoing, recruiting), Poland (ongoing, recruiting), Greece (ongoing, recruitment ended), Denmark (authorised, recruiting).
Therapeutic area(s): Diseases [C] - Neoplasms [C04]
Gender: Female, Male. Age: 18-64 years, 65+ years. Enrolment: 37.
Start date (EU): 2022-06-24. Decision date: 2023-04-27. Results received: No. Last updated: 2026-08-07.
Decision dates by country: PL: 2023-05-16, IT: 2023-05-16, FR: 2023-04-27, GR: 2024-12-10, DK: 2026-04-08

Condition(s): Relapsed or Refractory Diffuse Large B-Cell Lymphoma
Product: Truxima 500 mg concentrate for solution for infusion, MabThera 500 mg concentrate for solution for infusion, OXALIPLATIN, Ruxience 500 mg concentrate for solution for infusion, GEMCITABINE, Zilovertamab vedotin, MabThera 100 mg concentrate for solution for infusion, Zilovertamab vedotin, BENDAMUSTINE HYDROCHLORIDE, Ruxience 100 mg concentrate for solution for infusion

Primary endpoint: Percentage of Participants with Dose-limiting Toxicities (DLTs), Percentage of Participants with Adverse Events (AEs), Percentage of Participants who Discontinue Study Treatment due to AE, Overall Survival (OS), Progression-Free Survival (PFS)
Endpoint(s): Objective Response Rate (ORR), Duration of Response (DOR)

Source: https://euclinicaltrials.eu/ctis-public/view/2022-502646-27-00